EU clinical trial 2025-523511-11-00: A Phase 3, Randomized, Active- and Placebo-Controlled, Partially-Blinded Study to Compare the Efficacy and Safety of KAI-9531 Administered Once Weekly Versus Semaglutide and Placebo in Participants Living with Obesity Who Do Not Have Diabetes
Protocol code: K9531-3107
Sponsor: Kailera Therapeutics Inc. (Pharmaceutical company). Phase: Therapeutic confirmatory (Phase III). Countries: Poland (ongoing, recruiting), Bulgaria (ongoing, recruiting).
Therapeutic area(s): Diseases [C] - Nutritional and Metabolic Diseases [C18]
Gender: Female, Male. Age: 18-64 years, 65+ years. Enrolment: 268.
Status: Ongoing, recruiting. Start date (EU): 2026-06-24. Decision date: 2026-04-29. Results received: No. Last updated: 2026-07-24.
Decision dates by country: BG: 2026-05-04, PL: 2026-04-29

Condition(s): Obesity
Product: Identical to kai-9531 solution for injection without active drug, Wegovy 0.5 mg FlexTouch solution for injection in pre-filled pen, KAI-9531, KAI-9531, Wegovy 0.25 mg FlexTouch solution for injection in pre-filled pen, Wegovy 1.7 mg FlexTouch solution for injection in pre-filled pen, Wegovy 1 mg FlexTouch solution for injection in pre-filled pen, KAI-9531, Wegovy 2.4 mg FlexTouch solution for injection in pre-filled pen

Primary endpoint: Percent change in body weight (kg) from baseline at Week 76
Endpoint(s): controlled for Type I error From baseline at Week 76 Percentage of participants with ≥5%,≥10%, ≥15%, ≥20%, and ≥25% reduction in body weight (kg) Change in waist circumference (cm) Change in absolute body weight (kg), controlled for Type I error From baseline at Week 76 Percentage of participants with ≥5% reduction in body weight (kg) Change in - SBP − Triglycerides (mg/dL) − HDL-cholesterol (mg/dL) − Non-HDL-cholesterol (mg/dL) Change in WQOL-LiteCT Physical function composite score, not controlled for Type I error from baseline at Week 76: • Percentage of participants with ≥30% reduction in body weight (kg) • Change in BMI (kg/m2) • Change in: − CoEQ Craving Control score − Positive Mood score − Craving for Sweets score − Craving for Savory food score − Hunger score − Satiety score − Combined score • Change in FNQ score, not controlled for Type I error Number ofTEAEs, not controlled for Type I error ADA NAb, not controlled for Type I error Concentrations of KAI-9531

Source: https://euclinicaltrials.eu/ctis-public/view/2025-523511-11-00